EU clinical trial 2023-503214-68-00: Elacestrant in women and men with CDK4/6 Inhibitor-Naïve estrogen receptor positive, HER2 negative metastatic breast cancer: An open-label multicenter phase 2 study (ELCIN)
Protocol code: STML-ELA-0322
Sponsor: Stemline Therapeutics Inc. (Pharmaceutical company). Phase: Therapeutic exploratory (Phase II). Countries: Romania (ongoing, recruitment ended), Bulgaria (ongoing, recruitment ended).
Therapeutic area(s): Diseases [C] - Neoplasms [C04]
Gender: Female, Male. Age: 18-64 years, 65+ years. Enrolment: 30.
Status: Ongoing, recruitment ended. Start date (EU): 2024-01-31. Decision date: 2023-12-11. Results received: No. Last updated: 2026-07-13.
Decision dates by country: BG: 2023-12-11, RO: 2023-12-11

Condition(s): metastatic breast cancer
Product: ORSERDU 86 mg film-coated tablets, ORSERDU 345 mg film-coated tablets

Primary endpoint: Progression Free Survival (PFS), as per investigator’s assessment (PFS defined as time from the date of the first dose to the date of the first radiological documentation of disease progression or death, whichever comes first)
Endpoint(s): Objective Response Rate (ORR): proportion of patients who achieve a best overall response (BOR) of partial response (PR) or complete response (CR), Duration of Response (DoR): time from the date of first documented CR/PR until the first radiological documentation of disease progression or death, whichever comes first, Clinical Benefit Rate (CBR): proportion of patients who achieve a BOR of confirmed CR/PR or durable stable disease (duration at least 24 weeks from date of first dose), Overall Survival (OS): time from the date of the first dose to the date of death from any cause

Source: https://euclinicaltrials.eu/ctis-public/view/2023-503214-68-00